EU clinical trial 2023-510260-13-00: A study in healthy people to test how 2 different doses of BI 1291583 are taken up in the body when given in 3 different formulations.
Protocol code: 1397-0021
Sponsor: Boehringer Ingelheim International GmbH (Pharmaceutical company). Phase: Human Pharmacology (Phase I)- Other. Countries: Germany (ended).
Therapeutic area(s): Not possible to specify
Gender: Female, Male. Age: 18-64 years. Enrolment: 30.
Status: Ended. Start date (EU): 2024-10-21. End date (EU): 2025-05-14. Decision date: 2024-08-28. Results received: No. Last updated: 2025-02-26.

Condition(s): Healthy volunteer trial

Source: https://euclinicaltrials.eu/ctis-public/view/2023-510260-13-00